EU clinical trial 2024-517785-42-00: A Phase III, Multicenter, Randomized, Open-Label Study to Evaluate the Efficacy and Safety of Atezolizumab Given in Combination with Cabozantinib Versus Cabozantinib Alone in Patients With Inoperable, Locally Advanced, or Metastatic Renal Cell Carcinoma Who Experienced Radiographic Tumor Progression During or After Immune Checkpoint Inhibitor Treatment
Protocol code: WO41994
Sponsor: F. Hoffmann-La Roche AG (Pharmaceutical company). Phase: Therapeutic confirmatory (Phase III). Countries: Poland (ended), Germany (ended).
Therapeutic area(s): Diseases [C] - Neoplasms [C04]
Gender: Female, Male. Age: 18-64 years, 65+ years. Enrolment: 64.
Status: Ended. Start date (EU): 2020-10-08. End date (EU): 2025-03-24. End date: 2025-03-25. Decision date: 2024-11-01. Results received: Yes. Last updated: 2024-11-16.
Decision dates by country: DE: 2024-11-01, PL: 2024-11-16

Condition(s): Renal cell carcinoma (RCC)
Product: RO7047650, Tecentriq 1 200 mg concentrate for solution for infusion

Primary endpoint: 1. Progression-free survival as assessed by Independent Review Facility (IRF), 2. Overall survival
Endpoint(s): 1. Progression-free survival as assessed by investigators, 2. Investigator- and IRF-assessed objective response rate, 3. Investigator- and IRF-assessed duration of objective response, 4. Incidence and severity of adverse events, with severity determined according to National Cancer Institute Common Terminology Criteria for Adverse Events Version 5.0, 5. Change from baseline in targeted vital signs, 6. Change from baseline in targeted clinical laboratory test results, 7. Atezolizumab concentrations at specified timepoints (for atezolizumab + cabozantinib arm), 8. Cabozantinib concentrations at specified timepoints, 9. Prevalence of anti-drug antibodies (ADAs) to atezolizumab at baseline and incidence of ADAs to atezolizumab during the study (for atezolizumab+ cabozantinib arm)

Source: https://euclinicaltrials.eu/ctis-public/view/2024-517785-42-00